EU clinical trial 2023-507874-42-00: A phase 2 trial assessing Ifenprodil as a ReMyelinating repurpOsed Drug in Multiple Sclerosis – MODIF-MS
Sponsor: Assistance Publique Hopitaux De Paris (Hospital/Clinic/Other health care facility). Phase: Phase I and Phase II (Integrated)- Other. Countries: France (ongoing, recruiting).
Therapeutic area(s): Diseases [C] - Musculoskeletal Diseases [C05]
Gender: Female, Male. Age: 18-64 years. Enrolment: 80.
Start date (EU): 2024-08-27. Decision date: 2024-03-18. Results received: No. Last updated: 2024-03-18.

Condition(s): Multiple sclerosis

Source: https://euclinicaltrials.eu/ctis-public/view/2023-507874-42-00